EU clinical trial 2024-513589-20-00: An open-label, multi-center, phase I/II study to assess safety, efficacy, and cellular kinetics of YTB323 in participants with treatment-resistant generalized myasthenia gravis
Protocol code: CYTB323O12101
Sponsor: Novartis Pharma AG (Pharmaceutical company). Phase: Phase I and Phase II (Integrated)- Other. Countries: France (ongoing, recruiting).
Therapeutic area(s): Diseases [C] - Nervous System Diseases [C10]
Gender: Female, Male. Age: 18-64 years. Enrolment: 3.
Status: Ongoing, recruiting. Start date (EU): 2025-07-29. Decision date: 2025-03-05. Results received: No. Last updated: 2026-01-07.

Condition(s): Treatment-resistant generalized Myasthenia Gravis
Product: YTB323, Flebogamma DIF 50 mg/ml solution for infusion, TOCILIZUMAB, FLUDARABINE PHOSPHATE, CYCLOPHOSPHAMIDE

Primary endpoint: Occurrence, severity, and frequency of Adverse Events (AEs) (including CRS and ICANs) and change from baseline in safety parameters including, but not limited to: Vital signs, laboratory parameters, ECG, and neurological status
Endpoint(s): YTB323 transgene levels by qPCR over time in peripheral blood; cellular kinetics parameters (Cmax, AUC, Tmax, Clast, Tlast), Pre-existing and treatment induced immunogenicity (cellular, humoral, neutralizing antibodies) of YTB323, At various timepoints: • Change from BL of MG-ADL score • Change from BL of QMG total score • Whether or not patient achieves a ≥3-point reduction of QMG total score sustained for 6 months post BL • Whether or not patient achieves a ≥2-point reduction of MG-ADL score sustained for 6 months post BL • Whether or not a patient achieves MGFA Post intervention Status (PIS) of minimal manifestations (MM) or better and sustained for 6 months post BL

Source: https://euclinicaltrials.eu/ctis-public/view/2024-513589-20-00